EU clinical trial 2025-521459-22-00: A phase II, randomized, open-label, national, multicenter study evaluating the efficacy and safety of the combination of atezolizumab and bevacizumab as neoadjuvant plus adjuvant treatment in hepatocellular carcinoma (ASPIRE)
Protocol code: ASPIRE
Sponsor: Fundacio De Recerca Clinic Barcelona-Institut D’Investigacions Biomediques August Pi I Sunyer (Laboratory/Research/Testing facility). Phase: Therapeutic exploratory (Phase II). Countries: Spain (ongoing, recruiting).
Therapeutic area(s): Diseases [C] - Neoplasms [C04]
Gender: Female, Male. Age: 18-64 years, 65+ years. Enrolment: 90.
Status: Ongoing, recruiting. Start date (EU): 2026-03-27. Decision date: 2025-11-17. Results received: No. Last updated: 2025-11-17.

Condition(s): Patients with resectable hepatocellular carcinoma (amenable R0 resection) at high risk of recurrence.
Product: Tecentriq 1 200 mg concentrate for solution for infusion, Avastin 25 mg/ml concentrate for solution for infusion.

Primary endpoint: RFS, defined as the time from randomization to the first documented recurrence of disease according to RECIST v1.1 and mRECIST by the investigator’s radiology team, or death from any cause (whichever occurs first).
Endpoint(s): MPR rate, defined as the proportion of participants with > 70% necrosis of tumor in the tumor bed at the time of surgery, as assessed by central pathological review., Complete pathological response (pCR) rate, defined as the proportion of participants with an absence of residual tumor at the time of surgery, as assessed by central pathological review., OS, defined as the time from randomization to death from any cause., EFS, defined as time from randomization to predefined event, that may include disease progression/toxicity precluding surgery, relapse [ both assessed according to RECIST v1.1 and mRECIST by the investigator’s radiology team] or death., ORR, defined as the proportion of participants with a radiological CR or PR prior to surgery, as determined by the investigator according to RECIST v1.1 and HCC mRECIST. Responses will be assessed and determined according to RECIST v1.1 and HCC mRECIST but are not required to be confirmed by subsequent imaging assessments., R0 resection rate (proportion of resected participants obtaining an R0 resection). R0 resection is defined as a microscopically margin‑negative resection, in which no tumor (gross or microscopic) remains in the primary tumor bed., Incidence, nature, and severity of adverse events, serious adverse events, and immune-related adverse events (severity determined according to NCI CTCAE v5.0)., Proportion of participants with delayed or canceled surgery (defined as > 28 days from surgical restaging visit), as well as length of surgical delay, duration of surgery, length of hospital stays, surgical approach, extent of surgery, intraoperative blood loss, and need for intraoperative blood transfusion., Post-operative surgical complication rates according to the Clavien-Dindo surgical classification. Clinically relevant complications are defined as Clavien-Dindo Grade ≥ IIIa., Post-operative mortality, defined as death within 90 days after surgery.

Source: https://euclinicaltrials.eu/ctis-public/view/2025-521459-22-00